EU clinical trial 2025-522135-34-00: The effect of a superficial parasternal intercostal plane block in cardiac surgical patients undergoing conventional median sternotomy: a multicentric, double-blind, prospective, randomized controlled superiority trial.
Sponsor: UZ Leuven (Hospital/Clinic/Other health care facility). Phase: Phase III and phase IV (Integrated). Countries: Belgium (ongoing, recruiting).
Therapeutic area(s): Analytical, Diagnostic and Therapeutic Techniques and Equipment [E] - Anesthesia and Analgesia [E03]
Gender: Female, Male. Age: 18-64 years, 65+ years. Enrolment: 136.
Status: Ongoing, recruiting. Start date (EU): 2025-11-14. Decision date: 2025-10-01. Results received: No. Last updated: 2025-10-01.

Condition(s): Patients undergoing cardiac surgery through conventional median sternotomy access
Product: MINI-PLASCO NACL B. BRAUN 0,9 %, oplossing voor injectie, Naropin® 7,5 mg/ml Amp. 20 ml Injektionslösung

Primary endpoint: The primary outcome is the mean difference in QoR-15NL score between the verum bilateral SPIP block (intervention group) and the placebo bilateral SPIP block (control group) in patients undergoing cardiac surgery via conventional median sternotomy on the first postsurgical day, defined as 24 hours after surgical incision, assessed by the Dutch Quality of Recovery 15 items questionnaire.
Endpoint(s): The cumulative opioid consumption in the first 72 hours after surgical incision, Time to first rescue analgesia for breakthrough pain (e.g. oxycodone or piritramide) in the first 72 hours after surgical incision (in minutes)., The AUC of the reported dynamic NRS scores at predefined timepoints (assessed at 3, 6, 12, 24, 48, 72 hours) during the first 72 hours after surgical incision., The AUC of the reported dynamic NRS scores at predefined timepoints (assessed at 3, 6, 12, 24, 48, 72 hours) during the first 72 hours after surgical incision., Number of patients with PONV in the first 24 hours after surgical incision, Time spent in the ICU/PACU until fit for discharge (in hours)., Time spent in the hospital between surgical incision and the first hospital discharge (in hours)., Occurrence of respiratory complications, leading to non-invasive ventilation (NIV) or high-flow nasal cannula (HFNC) oxygen therapy, orotracheal intubation for more than 24 hours or orotracheal re-intubation, QoR-15NL score on the second (D2) after surgery, EQ-5D-5L score 30 days after surgery

Source: https://euclinicaltrials.eu/ctis-public/view/2025-522135-34-00